EU clinical trial 2023-509307-33-00: A Phase 1/2 Open-Label, Umbrella Platform Design Study of Investigational Agents With Pembrolizumab (MK-3475) and Chemotherapy in Participants With 1L Locally Advanced Unresectable/Metastatic Gastroesophageal Adenocarcinoma (Gastric Adenocarcinoma, Gastroesophageal Junction Adenocarcinoma, and Esophageal Adenocarcinoma): Substudy 06C
Protocol code: MK-3475-06C
Sponsor: Merck Sharp & Dohme LLC (Pharmaceutical company). Phase: Phase I and Phase II (Integrated)- Other. Countries: Norway (ongoing, recruiting), Italy (ongoing, recruiting), Germany (ongoing, recruiting), France (ongoing, recruiting).
Therapeutic area(s): Diseases [C] - Neoplasms [C04]
Gender: Female, Male. Age: 18-64 years, 65+ years. Enrolment: 26.
Status: Ongoing, recruiting. Start date (EU): 2024-09-26. Decision date: 2024-08-13. Results received: No. Last updated: 2026-04-17.
Decision dates by country: IT: 2024-08-13, DE: 2024-08-16, NO: 2024-08-13, FR: 2024-08-14

Condition(s): Gastroesophageal cancer
Product: CALCIUM FOLINATE, MK-2870, PARACETAMOL, MK-1022, KEYTRUDA 25 mg/mL concentrate for solution for infusion, CALCIUM LEVOFOLINATE, CAPECITABINE, MK-2870, FLUOROURACIL, OXALIPLATIN

Primary endpoint: Safety Lead-in Phase: Number of Participants Who Experience One or More Dose-Limiting Toxicities (DLTs), Safety Lead-in Phase: Number of Participants Who Experienced an Adverse Event (AE), Safety Lead-in Phase: Number of Participants Who Discontinued Study Intervention Due to an AE, Objective Response Rate (ORR) Per Response Evaluation Criteria in Solid Tumors Version 1.1 (RECIST 1.1) as Assessed by Blind Independent Review Committee (BICR)
Endpoint(s): Progression-Free Survival (PFS) per RECIST 1.1 as Assessed by BICR, Duration of Response (DOR) Per RECIST 1.1 as Assessed by BICR, Overall Survival (OS), Number of Participants Who Experience an Adverse Event (AE), Number of Participants Who Discontinue Study Treatment Due to an AE, Incidence of Antidrug Antibodies (ADA) to investigational agents – (sacituzumab tirumotecan (sac-TMT, MK-2870) and patritumab deruxtecan (HER3-DXd))

Source: https://euclinicaltrials.eu/ctis-public/view/2023-509307-33-00